EU clinical trial 2025-521615-39-00: A Phase 1, Open-Label, 2-Period, 2-Formulation, Within-Subject Crossover Comparative Pharmacokinetic, Pharmacodynamic, and Safety Study of 1 Dose Level of Aspirin for Injection and Oral Aspirin Tablets in Healthy Adult Human Subjects Under Fasting Conditions.
Protocol code: RHO-11-003
Sponsor: Rhoshan Pharmaceuticals Inc. (Pharmaceutical company). Phase: Human Pharmacology (Phase I)- Other. Countries: Czechia (ended).
Therapeutic area(s): Diseases [C] - Hemic and Lymphatic Diseases [C15]
Gender: Female, Male. Age: 18-64 years. Enrolment: 40.
Status: Ended. Start date (EU): 2025-06-04. End date (EU): 2025-07-14. Decision date: 2025-06-03. Results received: No. Last updated: 2025-06-03.

Condition(s): not applicable (submitted trial is a pharmacokinetic and pharmacodynamic safety study in healthy subjects)

Source: https://euclinicaltrials.eu/ctis-public/view/2025-521615-39-00